EU clinical trial 2023-508308-40-00: A Randomized, Phase 3, Open-label Study to Investigate the Pharmacokinetics and Safety of Subcutaneous Pembrolizumab versus Intravenous Pembrolizumab, Administered with Platinum Doublet Chemotherapy, in the First-Line Treatment of Participants with Metastatic Squamous or Nonsquamous Non-Small-Cell Lung Cancer
Protocol code: MK-3475-A86
Sponsor: Merck Sharp & Dohme LLC (Pharmaceutical company). Phase: Therapeutic confirmatory (Phase III). Countries: Hungary (ended), Romania (ended), Spain (ended), Poland (ended), France (ended).
Therapeutic area(s): Diseases [C] - Neoplasms [C04]
Gender: Female, Male. Age: 18-64 years, 65+ years. Enrolment: 215.
Status: Ended. Start date (EU): 2021-07-30. End date (EU): 2026-07-01. Decision date: 2024-03-25. Results received: No. Last updated: 2026-04-15.
Decision dates by country: RO: 2024-04-01, PL: 2024-06-10, ES: 2024-04-02, HU: 2024-03-25, FR: 2024-03-25

Condition(s): Metastatic (stage IV) squamous or nonsquamous non-small cell lung cancer (NSCLC).
Product: PEMETREXED, KEYTRUDA 25 mg/mL concentrate for solution for infusion, PACLITAXEL ALBUMIN-BOUND, CARBOPLATIN, PACLITAXEL, pembrolizumab, CISPLATIN

Primary endpoint: Area Under The Curve From 0-3 Weeks (AUC 0-3wks) of Pembrolizumab at Cycle 1, Cycle 6 Model-Based Minimal Concentration (Ctrough) of Pembrolizumab
Endpoint(s): Objective Response Rate (ORR) per Response Evaluation Criteria In Solid Tumors Version 1.1 (RECIST 1.1) as Assessed by Blinded Independent Central Review (BICR), Observed Ctrough of Pembrolizumab at the End of Cycle 1, Maximum Concentration (Cmax) of Pembrolizumab at Cycle 1, AUC 0-3wks of Pembrolizumab at Cycle 6, Cmax of Pembrolizumab at Cycle 6, Observed Ctrough of Pembrolizumab at the End of Cycle 6, Number of Participants Who Experienced an Adverse Event (AE), Number of Participants Who Discontinued Study Treatment Due to an AE, Progression-Free Survival (PFS) per RECIST 1.1 as Assessed by BICR, Overall Survival (OS), Duration of Response (DOR) per RECIST 1.1 as Assessed by BICR, Anti-Drug Antibodies (ADAs) Incidence After Administration of Pembrolizumab

Source: https://euclinicaltrials.eu/ctis-public/view/2023-508308-40-00